EU clinical trial 2025-524003-68-00: OBINUSS - Safety and efficacy of obinutuzumab in systemic sclerosis: a phase II, randomized, double-blinded versus placebo-controlled trial
Protocol code: APHP230826
Sponsor: Assistance Publique Hopitaux De Paris (Hospital/Clinic/Other health care facility). Phase: Therapeutic exploratory (Phase II). Countries: France (authorised, recruitment pending).
Therapeutic area(s): Diseases [C] - Immune System Diseases [C20]
Gender: Female, Male. Age: 18-64 years, 65+ years. Enrolment: 74.
Status: Authorised, recruitment pending. Decision date: 2026-07-28. Results received: No. Last updated: 2026-07-28.

Condition(s): Patients with newly or active diffuse Systemic sclerosis at the time of screening.
Product: Gazyvaro 1,000 mg concentrate for solution for infusion., Placebo of Gazyvaro (NaCl 0.9%)

Primary endpoint: Percentage of patients achieving a 20% CRISS improvement from baseline in at least 3 of the 5-core set second step leasures if the Revised CRISS at 360 days
Endpoint(s): 1 - Security profile: - Mortality up to 360 days - Occurrence of adverse events up to 360 days - Occurrence of severe adverse events up to 360 days. - Occurrence of adverse events of specific interest previously mentioned, 2-Proportion of patients who achieved CRISS20 of the revised CRISS at days 180 and 270 - Proportions of patients who achieved 30%, 40%, 50% ,60%, 70%, 80%, 90% and 100% improvement from baseline in at least 3 of the 5 core set measures of the revised CRISS at days 180, 270 and 360 - Change in the Combined Response Index in Diffuse Systemic Sclerosis (CRISS) score at days 180, 270 and day 360 - Physicians and patients visual analogue scales - See details of another secondary end point in protocol, 3 - Quality of life, disability, and patients reported outcomes - SF-36 and EQ5D5L scales at day 0, day 90, day 180, day 270 and day 360 - HAQ-DI and SHAQ scales at day 0, day 90, day 180, day 270 and day 360. - SSPRO, ScleroID, SGRQ, and KBILD scales at day 0, day 90, day 180, day 270 and day 360 - Saint Georges Respiratory Hospital Questionnaire and King Brief’s Interstitial Lung Disease questionnaires at day 0, day 90, day 180, day 270 and day 360

Source: https://euclinicaltrials.eu/ctis-public/view/2025-524003-68-00